EU clinical trial 2024-515765-34-00: A Phase III, multisite, double-blinded randomized trial of BNT327 in combination with chemotherapy (etoposide/carboplatin) compared to atezolizumab in combination with chemotherapy (etoposide/carboplatin) in participants with first-line extensive-stage small-cell lung cancer
Protocol code: BNT327-03
Sponsor: BioNTech SE (Pharmaceutical company). Phase: Therapeutic confirmatory (Phase III). Countries: Poland (ongoing, recruiting), Spain (ongoing, recruiting), France (ongoing, recruiting), Italy (ongoing, recruiting), Germany (ongoing, recruiting), Romania (ongoing, recruiting), Netherlands (authorised, recruitment pending).
Therapeutic area(s): Diseases [C] - Neoplasms [C04]
Gender: Female, Male. Age: 18-64 years, 65+ years. Enrolment: 249.
Start date (EU): 2026-02-04. Decision date: 2025-12-22. Results received: No. Last updated: 2026-04-17.
Decision dates by country: FR: 2025-12-24, IT: 2025-12-22, ES: 2026-02-18, DE: 2026-02-16, PL: 2025-12-23, RO: 2026-04-17, NL: 2026-04-16

Condition(s): English First-line extensive-stage small-cell lung cancer (ES-SCLC)
Product: Tecentriq 1 200 mg concentrate for solution for infusion, CISPLATIN, CARBOPLATIN, BNT327, ETOPOSIDE

Primary endpoint: Overall survival (OS) defined as the time from randomization to death from any cause.
Endpoint(s): Progression-free survival (PFS) defined as the time from randomization to first objective tumor progression, or death from any cause, whichever occurs first., Objective response rate (ORR) defined as the proportion of participants in whom a complete response (CR) or partial response (PR) is observed as best overall response with confirmation., Duration of response (DOR) defined as the time from onset of objective response (confirmed CR or PR based on investigator’s assessment) to first occurrence of objective tumor progression (progressive disease) or death from any cause, whichever occurs first., Progression-free survival (PFS) rate based on investigator’s assessment at 6, 12, and 18 months., Overall survival (OS) rate at 6, 12, 18, and 24 months., Occurrence of treatment-emergent adverse events (TEAEs) including Grade ≥3, serious, and fatal TEAEs, by relationship., Occurrence of dose delay, infusion interruption, and discontinuation of study treatment due to TEAEs (including related TEAEs), Change from baseline in EORTC QLQ-C30 Global Health status / Quality-of-Life score (Items 29 and 30)., Change from baseline in EORTC QLQ-C30 physical functioning, Change from baseline in coughing scale of the EORTC quality-of-life-Lung cancer 29 questionnaire (QLQ-LC29)., Change from baseline in shortness of breath scale of the EORTC QLQ-LC29., Change from baseline in "coughed up blood item" of the EORTC QLQ-LC29, Change from baseline in the Functional Assessment of Cancer Therapy overall bother item (FACT-GP5).

Source: https://euclinicaltrials.eu/ctis-public/view/2024-515765-34-00